EU clinical trial 2024-519531-41-00: Efficacy and safety of cagrilintide for weight management in participants with overweight or obesity and type 2 diabetes
Protocol code: NN9833-8243
Sponsor: Novo Nordisk A/S (Pharmaceutical company). Phase: Therapeutic confirmatory (Phase III). Countries: Czechia (ongoing, recruitment ended), Romania (ongoing, recruitment ended), Croatia (ongoing, recruitment ended), Slovakia (ongoing, recruitment ended), Hungary (ongoing, recruitment ended).
Therapeutic area(s): Diseases [C] - Nutritional and Metabolic Diseases [C18]
Gender: Female, Male. Age: 18-64 years, 65+ years. Enrolment: 130.
Status: Ongoing, recruitment ended. Start date (EU): 2025-10-31. Decision date: 2025-10-29. Results received: No. Last updated: 2026-08-07.
Decision dates by country: SK: 2025-10-29, RO: 2025-11-03, HR: 2025-11-03, HU: 2025-10-31, CZ: 2025-10-29

Condition(s): Overweight and obesity
Product: cagrilintide, cagrilintide, cagrilintide, cagrilintide, Placebo

Primary endpoint: Relative change in body weight., Achievement of ≥ 5% body weight reduction.
Endpoint(s): Achievement of ≥ 10% body weight reduction., Achievement of ≥ 15% body weight reduction., Change in waist circumference., Ratio to baseline in triglycerides., Ratio to baseline in hsCRP., Change in Impact of Weight on Quality of Life-Lite Clinical Trials Version (IWQOL-Lite-CT) Physical Function score., Change in body weight., Change in SF-36v2® Health Survey Acute (SF-36v2® Acute) physical component summary score., Change in SF-36v2® mental component summary score., Change in IWQOL-Lite-CT total score., Achievement of at least 14.6-point increase (yes/no) in IWQOL-Lite-CT Physical Function score., Change in systolic blood pressure., Change in diastolic blood pressure., Ratio to baseline of: Total cholesterol High-density lipoprotein (HDL) cholesterol Low-density lipoprotein (LDL) cholesterol Very low-density lipoprotein (VLDL) cholesterol Non-HDL cholesterol Free fatty acids CCI CCI, Change in glycated haemoglobin (HbA1c)., Change in fasting plasma glucose., Ratio to baseline in fasting serum insulin., Number of treatment emergent adverse events., Number of treatment emergent serious adverse events., Number of clinically significant hypoglycaemic episodes (level 2): <3.0 mmol/L [54 mg/dL], confirmed by BG meter, Number of severe hypoglycaemic episodes (level 3): hypoglycaemia associated with severe cognitive impairment requiring external assistance for recovery, with no specific glucose threshold

Source: https://euclinicaltrials.eu/ctis-public/view/2024-519531-41-00